EU clinical trial 2022-502022-41-00: A Phase 1, Randomized, Observer-blind, Placebo-controlled, Age De-escalation Study of the Safety, Tolerability, and Immunogenicity of mRNA-1345 and mRNA-1365 in Participants Aged 5 months to < 24 months
Protocol code: mRNA-1365-P101
Sponsor: Moderna Inc. (Pharmaceutical company). Phase: Human Pharmacology (Phase I)- Other. Countries: Spain (ended), Latvia (ended), Poland (ended).
Therapeutic area(s): Diseases [C] - Virus Diseases [C02]
Gender: Female, Male. Age: 0-17 years. Enrolment: 248.
Status: Ended. Start date (EU): 2024-05-28. End date (EU): 2024-12-18. Decision date: 2023-08-23. Results received: No. Last updated: 2024-09-24.
Decision dates by country: LV: 2023-08-28, PL: 2023-08-28, ES: 2023-08-23

Condition(s): Acute lower respiratory infection
Product: Nimenrix powder and solvent for solution for injection in pre-filled syringe Meningococcal groups A, C, W-135 and Y conjugate vaccine, mRNA-1365, mRNA-1345, SODIUM CHLORIDE SOLUTION 0.9%, SODIUM CHLORIDE SOLUTION 0.9%

Primary endpoint: Solicited local and systemic ARs through 7 days after each injection., Unsolicited AEs through 28 days after each injection., MAAEs from Day 1 to EoS., AESIs from Day 1 to EoS., SAEs from Day 1 to EoS., AEs leading to discontinuation from Day 1 to EoS.
Endpoint(s): Number and percentage of participants with RTI, LRTI, severe LRTI, very severe LRTI, and hospitalizations associated with RSV or hMPV from Day 1 through EoS., GMT of serum RSV and hMPV neutralizing antibody across prespecified study timepoints. In Part C and Part D, GMT and GMC will be done only for RSV., GMC of serum RSV F and hMPV F– binding antibody across prespecified study timepoints. In Part C and Part D, GMT and GMC will be done only for RSV., GMFR of postbaseline/baseline neutralizing antibody titers and binding antibody concentrations across prespecified study timepoints., Frequency, magnitude, and/or phenotype of vaccine-specific T-cell responses measured by flow cytometry or other methods. Cellular immunogenicity will not be done in Part B and Part D.

Source: https://euclinicaltrials.eu/ctis-public/view/2022-502022-41-00